EU clinical trial 2024-516675-32-00: A Multi-Center, Open Label, Uncontrolled, Phase II Clinical Trial Evaluating the Safety and Efficacy of Venetoclax in Combination with Atezolizumab and Obinutuzumab in Richter Transformation of CLL
Protocol code: MOLTO
Sponsor: ASST Grande Ospedale Metropolitano Niguarda (Hospital/Clinic/Other health care facility). Phase: Therapeutic exploratory (Phase II). Countries: Italy (ended).
Therapeutic area(s): Diseases [C] - Hemic and Lymphatic Diseases [C15]
Gender: Female, Male. Age: 18-64 years, 65+ years. Enrolment: 14.
Status: Ended. Start date (EU): 2019-10-08. End date (EU): 2025-11-30. Decision date: 2024-11-04. Results received: No. Last updated: 2026-02-10.

Condition(s): Richter syndrome of chronic lymphocytic leukemia
Product: Venclexta, Venclyxto, Tecentriq 1 200 mg concentrate for solution for infusion, Venclexta, Venclyxto, Venclexta, Venclyxto, Gazyvaro 1,000 mg concentrate for solution for infusion.

Primary endpoint: The treatment will be considered effective if the combination enables the achievement of a minimum of 67% ORR at the end of the sixth cycle. Patients will be evaluated according to Lugano Criteria for aggressive lymphomas (Cheson et al. JCO, 2014). Residual underlying CLL may persist in node and/or marrow and still qualify as CR, denoting complete response of RT to treatment (Hallek M et al. IwCLL Criteria Blood 2008).
Endpoint(s): Incidence of adverse events (AE) and serious adverse event (SAE) as measured per NCICTCAE v4.0; significant laboratory abnormality and dose tolerability (dose modifications and discontinuation)., Assessment of the efficacy of the combination of obinutuzumab, atezolizumab and venetoclax with respect to: - Complete Remission Rate (CRR) - Duration of Response (DoR) - Progression Free Survival (PFS) - Overall Survival (OS).

Source: https://euclinicaltrials.eu/ctis-public/view/2024-516675-32-00